EU clinical trial 2024-512837-34-00: A Multicenter, Open-Label Study Evaluating the Long-Term Safety, Tolerability, and Efficacy of Monthly Subcutaneous Administration of Fremanezumab for the Preventive Treatment of Episodic and Chronic Migraine in Pediatric Patients 6 to 17 Years of Age
Protocol code: TV48125-CNS-30084
Sponsor: Teva Branded Pharmaceutical Products R&D LLC (Pharmaceutical company). Phase: Therapeutic confirmatory (Phase III). Countries: Finland (ended), Spain (ended), Italy (ended), Germany (ended), Netherlands (ended), Poland (ended).
Therapeutic area(s): Diseases [C] - Nervous System Diseases [C10]
Gender: Female, Male. Age: 0-17 years. Enrolment: 263.
Status: Ended. Start date (EU): 2020-10-14. End date (EU): 2025-12-22. End date: 2025-12-23. Decision date: 2024-10-04. Results received: Yes. Last updated: 2025-09-22.
Decision dates by country: ES: 2024-10-04, NL: 2024-10-07, IT: 2024-11-20, FI: 2024-10-09, PL: 2024-11-13, DE: 2024-10-17

Condition(s): Episodic and Chronic Migraine
Product: Fremanezumab, AJOVY 225 mg solution for injection in pre-filled pen

Primary endpoint: Safety: Occurrence of adverse events throughout the trial, including local injection site reactions/pain, Changes from baseline in clinical laboratory (serum chemistry, hematology, coagulation, and urinalysis) test results and height and weight measurements taken at V5, V8, and at the end of treatment (V11), Abnormal standard 12-lead electrocardiogram findings at each trial visit up to the end of treatment (V11), Changes from baseline in vital signs (pulse, systolic and diastolic blood pressure, temperature, and respiratory rate) at each trial visit up to the end of treatment (V11), Abnormal physical examination findings at trial visits V6, V7, V11, and V12, Suicidal ideation and behavior as suggested by the Columbia-Suicide Severity Rating Scale throughout the trial
Endpoint(s): Efficacy: Mean change from baseline (defined as the original baseline from the EM and CM studies) in the number of headache days of at least moderate severity during the 4-week periods after V2, V6, and V10, Mean change from baseline (defined as the original baseline from the EM and CM studies) in the number of migraine days during the 4-week periods after V2, V6, and V10, Proportion of participants reaching at least 50% reduction in the number of migraine days during the 4-week periods after V2, V6, and V10, Proportion of participants reaching at least 50% reduction in the number of headache days of at least moderate severity during the 4- week periods after V2, V6, and V10, Mean change from baseline (defined as the original baseline from the EM and CM studies) in the number of days of use of any acute headache medications during the 4-week periods after V2, V6, and V10, Mean change from baseline (day 1) in migraine-related disability score, as measured by the PedMIDAS questionnaire at V5, V8, V11, and V12, Proportion of participants developing ADAs throughout the trial. The impact of ADAs on safety and efficacy will be analyzed if the number of ADA-positive participants allows

Source: https://euclinicaltrials.eu/ctis-public/view/2024-512837-34-00